EU clinical trial 2024-518938-81-00: Combined Nabpaclitaxel Pressurized IntraPeritoneal Aerosol Chemotherapy with systemic Nabpaclitaxel-Gemcitabine chemotherapy for pancreatic cancer peritoneal metastases. A single-arm, open-label, phase II trial. Nab-PIPAC Trial
Protocol code: Nab-PIPAC
Sponsor: Fondazione Policlinico Universitario Agostino Gemelli IRCCS (Hospital/Clinic/Other health care facility). Phase: Therapeutic exploratory (Phase II). Countries: Italy (ongoing, recruiting).
Therapeutic area(s): Diseases [C] - Neoplasms [C04]; Diseases [C] - Digestive System Diseases [C06]
Gender: Female, Male. Age: 18-64 years, 65+ years. Enrolment: 38.
Status: Ongoing, recruiting. Start date (EU): 2022-03-09. Decision date: 2024-12-02. Results received: No. Last updated: 2024-12-02.

Condition(s): Pancreatic cancer with peritoneal metastases
Product: GEMCITABINE, PACLITAXEL, PACLITAXEL

Primary endpoint: The Disease Control Rate (DCR), defined as the combined incidence of complete response (CR), partial response (PR) and stable disease (SD) for ≥ 16 weeks measured during study treatments and at the End of Treatment visit according to the RECIST criteria v. 1.1
Endpoint(s): The compliance to treatment assessed: - The number of patients unable to undergo six cycles of systemic chemotherapy combined with three PIPAC cycles and reasons for discontinuation - The number of patients who discontinued or postponed beyond 10 days the scheduled standard systemic chemotherapy after each PIPAC cycle. - The number of patients that reduce the dose of systemic chemotherapy during the study; - The number of patients that reduce the dose of PIPAC drug during the study;, The safety and toxicity assessed: - The number of patients with major toxicity, defined as grade ≥3 according to CTCAE v. 5.0, during treatment period and up to 4 weeks after the last combined course; The number of patients with minor toxicity, defined as grade ≤2 according CTCAE v. 5.0 during the treatment period and up to 4 weeks after the last combined course; The number of patients with major and minor postoperative complications, defined as grade ≥3 and grade ≤2 according to Clavien-Dindo,, The antitumoral activity of the proposed treatment will be assessed also through: - the pathological tumor response, based on review of peritoneal biopsies collected during each PIPAC, performed by a pathologist blinded to clinical outcomes using the Peritoneal Regression Grading Score (PRGS). A patient will be considered a responder if a reduction in the PRGS during subsequent biopsies will be recorded - the modifications of the Peritoneal Cancer Index (PCI) recorded by the surgeon during eac, The quality of life of the population will be assessed through the potential changes in quality of life scores extracted from the questionnaire QLQ-C30 at different time points, The Progression Free Survival (PFS), defined as the time between treatment start and one of the following events, whichever comes first: - radiologic progression based on RECIST criteria v. 1.1, - clinical progression (ie bowel occlusion, inability to oral feeding, refractory ascites), - death;, The Overall Survival (OS), defined as the time between study treatment start and death;, Exploratory endpoints - The intravenous area under the curve (AUC) of paclitaxel. The concentration or penetration of paclitaxel in peritoneal samples. The penetration of paclitaxel in peritoneal tissues - Nutritional parameters collected along the study period by blood samples, anthropometric and bio-impedancemetric evaluations, and body composition analysis based on CT scan images, Translational research endpoints - The germline mutational profile from blood samples - The genomic mutational profile of PM biopsies taken during PIPAC procedures; - The transcriptomic profile of PM biopsies taken during PIPAC procedures; - The tumor cells and tissue microenvironments, including immune system cells; - The circulating cytokines and immune cells profiles.

Source: https://euclinicaltrials.eu/ctis-public/view/2024-518938-81-00